EU clinical trial 2022-501912-32-00: DANNOAC- The Danish Non-vitamin K Antagonist Oral Anticoagulation Study
Sponsor: Bispebjerg Hospital, Gentofte Hospital (Hospital/Clinic/Other health care facility). Phase: Therapeutic use (Phase IV). Countries: Denmark (ongoing, recruitment ended).
Therapeutic area(s): Diseases [C] - Cardiovascular Diseases [C14]
Gender: Female, Male. Age: 18-64 years, 65+ years. Enrolment: 16340.
Status: Ongoing, recruitment ended. Start date (EU): 2023-04-01. Decision date: 2022-11-14. Results received: No. Last updated: 2023-07-17.

Condition(s): Atrial Fibrillation (and atrial flutter), deep vein trombosis and pulmonary embolism
Product: DABIGATRAN ETEXILATE, APIXABAN, RIVAROXABAN, EDOXABAN

Primary endpoint: DANNOAC-AF: A composite endpoint of stroke, myocardial infarction, thromboembolic event or all-cause death. DANNOAC-VTE: A composite endpoint of new venous thromboembolism or all-cause death.
Endpoint(s): Individual endpoints of the primary endpoint.

Source: https://euclinicaltrials.eu/ctis-public/view/2022-501912-32-00